EU clinical trial 2023-505106-41-01: UrsoDeoxyCholic Acid (UDCA) as neuroprotective treatment adjuvant to rhegmatogenous retinal detachment surgery
Protocol code: 2021_0025
Sponsor: Hospital Foch (Hospital/Clinic/Other health care facility). Phase: Therapeutic confirmatory (Phase III). Countries: France (ongoing, recruiting).
Therapeutic area(s): Diseases [C] - Eye Diseases [C11]
Gender: Female, Male. Age: 18-64 years, 65+ years. Enrolment: 120.
Status: Ongoing, recruiting. Start date (EU): 2024-08-20. Decision date: 2024-02-21. Results received: No. Last updated: 2024-02-21.

Condition(s): rhegmatogenous retinal detachment
Product: URSOLVAN 200 mg, gélule, Substance : lactose; Forme pharmaceutique : gélule Source : Cooper (Melun, France), fournisseur de matières premières pharmaceutiques Unité : 1 gélule constitue 1 unité de prise et contient 100% de lactose et 0 mg d’acide ursodésoxycholique Durée du traitement : 4 semaines; Voie d’administration : orale Posologie : 2 gélules par jour à avaler avec un verre d’eau pendant ou en dehors des repas

Primary endpoint: Simple endpoint: - Difference in visual recovery (difference between pre-operative and post-operative visual acuity) at 3 months post-operatively (after a successful reapplication procedure) (EDTRS scale) between the 2 groups (treatment and placebo)
Endpoint(s): CNE thickness, measured by SD-OCT, in the central 1 and 3 mm relative to the contralateral eye in the treatment group versus the placebo group (measurement adjusted relative to the contralateral eye to eliminate interindividual variability) at 1, 3 and 6 months., Automated microperimetry at 1, 3 and 6 months: difference in macular sensitivity between the 2 groups., Measuring contrast sensitivity on the Clinic CSF2.012 application, Presence/absence of abnormal signs on optical coherence tomography (OCT) images (cysts, folds, membrane, ellipsoid zone, outer limiting membrane, etc.)., Retinal thickness of different layers measured on OCT (retinal layers and presence of cysts segmentation of layers and measurement on central 1 and 3 mm in ETDRS quadrants)., Number of macular cones and pigment epithelium cells (RPE) measured by Adaptive Optics at 1, 3 and 6 months with the Cellularis device, which visualizes cones and RPE 13, Blood test: liver parameters: AST (SGOT), ALT (SGPT), PAL and γ -GT., Evolution of best visual acuity measured at D0, D7, D30, D60, D90 and D180: difference between treatment and placebo groups in visual acuity progression curves., Presence of metamorphospises., Tolerance and occurrence of adverse events, National Eye Institute Visual Functioning Questionnaire-25 (NEIVFQ-25) before surgery, at D±7 post-op and at 3 months post-op., Correlation between levels of proteins, bile acids or other molecular markers in ocular fluids and/or blood and pre- and post-operative functional and anatomical ocular parameters at different observation times., Correlation between effective treatment duration and functional and anatomical results at different observation times.

Source: https://euclinicaltrials.eu/ctis-public/view/2023-505106-41-01